EU clinical trial 2022-502846-28-00: Allogeneic adipose tissue derived-stem cells in Alzheimer disease
Protocol code: RC31/19/0501
Sponsor: Centre Hospitalier Universitaire De Toulouse (Hospital/Clinic/Other health care facility). Phase: Human Pharmacology (Phase I)- Other. Countries: France (ongoing, recruiting).
Therapeutic area(s): Diseases [C] - Nervous System Diseases [C10]
Gender: Female, Male. Age: 18-64 years, 65+ years. Enrolment: 9.
Status: Ongoing, recruiting. Start date (EU): 2026-05-07. Decision date: 2025-05-07. Results received: No. Last updated: 2026-02-09.

Condition(s): Alzheimer

Source: https://euclinicaltrials.eu/ctis-public/view/2022-502846-28-00